EU clinical trial 2022-501029-19-00: Symptoms control and adhErenCe assessment during treatment with mepolizUmab new pREfilled devices. SECURE
Protocol code: 69HCL21_0419
Sponsor: Hospices Civils De Lyon (Hospital/Clinic/Other health care facility). Phase: Therapeutic use (Phase IV). Countries: France (ended).
Therapeutic area(s): Diseases [C] - Respiratory Tract Diseases [C08]
Gender: Female, Male. Age: 18-64 years, 65+ years. Enrolment: 130.
Status: Ended. Start date (EU): 2022-12-13. End date (EU): 2025-03-27. Decision date: 2022-10-03. Results received: No. Last updated: 2024-01-15.
Decision dates by country: FR: 2022-11-09

Condition(s): Asthma
Product: SPIRIVA RESPIMAT 2,5 microgrammes/dose, solution à inhaler, Enerzair Breezhaler 114 micrograms/46 micrograms/136 micrograms inhalation powder, hard capsules, Innovair NEXThaler 200 microgrammes/6 microgrammes par dose, poudre pour inhalation., Relvar Ellipta 92 micrograms/22 micrograms inhalation powder, pre-dispensed, Revinty Ellipta 92 micrograms/22 micrograms inhalation powder, pre-dispensed, PROPIONATE DE FLUTICASONE/SALMETEROL VIATRIS 500 microgrammes/50 microgrammes/dose, poudre pour inhalation en récipient unidose, TIOTROPIUM VIATRIS 18 microgrammes, poudre pour inhalation en gélule, Seebri Breezhaler 44 micrograms inhalation powder, hard capsules, SPIRIVA 18 microgrammes poudre pour inhalation en gélule, Nucala 100 mg solution for injection in pre-filled syringe, Nucala 100 mg solution for injection in pre-filled pen, SERETIDE DISKUS 500 microgrammes/50 microgrammes/dose, poudre pour inhalation en récipient unidose, Symbicort Turbuhaler 400/12, 400 microgram / 12 microgram per dosis, inhalatiepoeder, PROPIONATE DE FLUTICASONE/SALMETEROL BIOGARAN AIRMASTER 500 microgrammes/ 50 microgrammes/dose, poudre pour inhalation en récipient unidose, Formodual NEXThaler 200 microgrammes/6 microgrammes par inhalation, poudre pour inhalation, Incruse Ellipta 55 micrograms inhalation powder, pre-dispensed, DuoResp Spiromax 160 micrograms / 4.5 micrograms inhalation powder, Trimbow 87 micrograms/5 micrograms/9 micrograms pressurised inhalation, solution

Primary endpoint: Composite endpoint: Treatment compliance using Pharmacy accountability of study treatment and monthly patient diary after 6 months of treatment with Mepolizumab. Patient will be considered as compliant if all treatment doses of period have been used. Proportion of compliant patients will be compared between groups of patients. Proportion of patients with controlled asthma using the ACT score, after a period of 6 months of treatment with Mepolizumab will be compared between groups of patients.
Endpoint(s): Proportion of patients with asthma control assessed by the ACT score between: group receiving Mepolizumab self-administered, using PFS and group receiving M. self-administered using an AI from 6 months to 12 months (between groups A2 and B2); M. administered by a PFS by a nurse for first 6 months & self-administered by a PFS for the following 6 months between groups A1 and A2; M. self-administered by an AI during first 6 months &self-administered by an AI the 6 months between groups B1 and B2, 2. Comparison of the mean change in ACT score from baseline between groups: A1 vs B1, A2 vs B2, A1 vs A2, B1 vs B2, and A vs B, 3. Comparison of the proportion of patients with a change in ACT score of at least 4 points from baseline between groups: A1 vs B1, A2 vs B2, A1 vs A2, B1 vs B2, and A vs B, 4. Comparison of the proportion of patients with an exacerbation of asthma during the 12 months of treatment (between groups A and B), 5. Comparison of the proportion of patients with an exacerbation of asthma requiring an emergency service visit or hospitalization during the 12 months of treatment (between groups A and B), 6. Comparison of the proportion of patients with an exacerbation of asthma during the 12 months of treatment with Mepolizumab versus the proportion of patients with an exacerbation of asthma during the 12 months prior to treatment with Mepolizumab, 7. The proportion of patients requiring unscheduled medical consultation for asthma during the 12 months of treatment (between groups A and B), 8. Cumulative dose of oral corticosteroids before and after 12 months of treatment with Mepolizumab (exacerbation treatment excluded) between group A and B, 9. Treatment compliance using the MARS-5 questionnaire administered after 6 and 12 months of treatment with Mepolizumab. The MARS-5 score will be compared between both groups of patients., 10. Carrying out a FeNO at V1, V2 and V3 after 6 and 12 months of Mepolizumab treatment between groups A and B, 11. Performing a hemogram on peripheral blood to measure eosinophilia evolution at M0, M3, M6, M9 and M12, 12. FEV1 measurement, % of theoretical FEV1 value, FEV1 / FVC at V1, V2 and V3, 13. Collection of adverse events related to the study treatment, according to grade 1 to 5., 14. Calculation of the mini-AQLQ quality of life score and SNOT-22 score at V1, V2 and V3, 15. Patient satisfaction questionnaire SATQ-F at V1, V2 and V3 and assessment of the preferences of patients in each group with respect to the Mepolizumab administration system at V1, V2 and V3, 15.16. Calculation of mMRC score for dyspnea at V1, V2 and V3 visits

Source: https://euclinicaltrials.eu/ctis-public/view/2022-501029-19-00